EU clinical trial 2025-522312-16-00: J2S-MC-GZMP: A Phase 3, Multicenter, Randomized, Double-Blind Study to Investigate the Efficacy and Safety of Brenipatide Compared With Placebo for the Treatment of Adult Participants With Alcohol Use Disorder (RENEW-ALC-2)
Protocol code: J2S-MC-GZMP
Sponsor: Eli Lilly & Co. (Pharmaceutical company). Phase: Therapeutic confirmatory (Phase III). Countries: Germany (ongoing, recruiting), Belgium (ongoing, recruiting).
Therapeutic area(s): Psychiatry and Psychology [F] - Behavioral Disciplines and Activities [F04]
Gender: Female, Male. Age: 18-64 years. Enrolment: 151.
Status: Ongoing, recruiting. Start date (EU): 2026-02-27. Decision date: 2026-01-29. Results received: No. Last updated: 2026-07-20.
Decision dates by country: DE: 2026-01-29, BE: 2026-02-06

Condition(s): Alcohol Use Disorder
Product: Placebo to match LY, Brenipatide, Brenipatide, Brenipatide

Primary endpoint: Behaviors Associated with Alcohol Use Disorder (AUD) as Assessed by the Timeline Followback Method (TLFB)

Source: https://euclinicaltrials.eu/ctis-public/view/2025-522312-16-00